EU clinical trial 2024-517458-90-00: A Randomised, Double-blind, Placebo-controlled, Parallel Group, Multicentre, Phase III Study to Evaluate the Efficacy and Safety of Tezepelumab in Adult Participants with Moderate to Very Severe Chronic Obstructive Pulmonary Disease (EMBARK)
Protocol code: D5241C00006
Sponsor: AstraZeneca AB (Pharmaceutical company). Phase: Therapeutic confirmatory (Phase III). Countries: Spain (ongoing, recruiting), Czechia (ongoing, recruiting), Denmark (ongoing, recruiting), Slovakia (ongoing, recruiting), Germany (ongoing, recruiting), Italy (ongoing, recruiting), Poland (ongoing, recruiting).
Therapeutic area(s): Diseases [C] - Respiratory Tract Diseases [C08]
Gender: Female, Male. Age: 18-64 years, 65+ years. Enrolment: 187.
Status: Ongoing, recruiting. Start date (EU): 2025-06-06. Decision date: 2025-05-12. Results received: No. Last updated: 2026-04-29.
Decision dates by country: CZ: 2025-05-14, DE: 2025-05-13, ES: 2025-05-16, SK: 2025-05-12, DK: 2025-05-12, IT: 2025-05-20, PL: 2025-07-30

Condition(s): Chronic obstructive pulmonary disease (COPD)
Product: Tezepelumab-placebo, Tezspire 210 mg solution for injection in pre-filled syringe

Primary endpoint: Annualised rate of moderate or severe COPD exacerbations up to 76 weeks
Endpoint(s): 1. Change from baseline in pre-BD FEV1 at Week 52, 3. Change from baseline in the SGRQ total score over 52 weeks, 4. Annualised rate of moderate or severe COPD exacerbations up to 76 weeks among participants with screening EOS ≥ 300 cells/μL., 5. Annualised rate of severe COPD exacerbations requiring ER visits and/or hospitalisations up to 76 weeks., 6. Participants achieving a clinically meaningful improvement from baseline in SGRQ total score (4-point score decrease) over 52 weeks., 7. Change from baseline in the CAT total score over 52 weeks, 8. Participants achieving a clinically meaningful improvement frombaseline in CAT total score (2-point score decrease) over 52 weeks., 9. Time to first moderate to severe COPD exacerbation up to 76 weeks, 10. Time to first severe COPD exacerbation up to 76 weeks, 11. PK: Serum trough concentrations, 12. Immunogenicity: Incidence of anti-drug antibodies and neutralising antibodies, 2. Change from baseline in post-BD FEV1 at Week 52.

Source: https://euclinicaltrials.eu/ctis-public/view/2024-517458-90-00